EU clinical trial 2023-509946-36-00: Conducting a quality study of the medicinal product - Vortioxetine
Protocol code: CBF23001
Sponsor: CCDRD Cooperative Clinical Drug Research and Development AG, Biofarm Sp. z o.o. (Pharmaceutical company). Phase: Human Pharmacology (Phase I)- Bioequivalence Study. Countries: Bulgaria (ended).
Therapeutic area(s): Diseases [C] - Nervous System Diseases [C10]
Gender: Female, Male. Age: 18-64 years. Enrolment: 36.
Status: Ended. Start date (EU): 2024-06-29. End date (EU): 2024-08-15. Decision date: 2024-04-01. Results received: No. Last updated: 2024-07-29.

Condition(s): No therapeutic indication in the current trial with healthy volunteers. The intended indication is for the treatment of major depressive episodes in adults

Source: https://euclinicaltrials.eu/ctis-public/view/2023-509946-36-00